EU clinical trial 2025-523670-17-00: Multinational, Interventional, 52-week, Open-label, Single-arm Study to Evaluate the Treatment Outcomes of Anifrolumab 120 mg Subcutaneous Once Weekly in Immunosuppressant-naïve and Biologic-naïve Systemic Lupus Erythematosus (SUNFLOWER)
Protocol code: D3461C00040
Sponsor: AstraZeneca AB (Pharmaceutical company). Phase: Therapeutic confirmatory (Phase III). Countries: Poland (ongoing, recruiting), Germany (authorised, recruitment pending), Italy (authorised, recruitment pending), France (authorised, recruitment pending), Spain (authorised, recruiting).
Therapeutic area(s): Diseases [C] - Immune System Diseases [C20]
Gender: Female, Male. Age: 18-64 years, 65+ years. Enrolment: 108.
Start date (EU): 2026-07-10. Decision date: 2026-06-02. Results received: No. Last updated: 2026-07-29.
Decision dates by country: FR: 2026-06-02, ES: 2026-06-08, IT: 2026-06-03, DE: 2026-06-03, PL: 2026-06-05

Condition(s): Systemic lupus erythematosus
Product: Saphnelo 120 mg solution for injection in pre-filled syringe

Primary endpoint: Proportion of participants who are in DORIS remission at Week 52
Endpoint(s): 1. Proportion of participants who are in LLDAS, or LLDAS- 5 at Week 28 and 52, 2. Proportion of time spent in DORIS remission, in LLDS and LLDAS-5, 3. Proportion of participants who achieve DORIS, LLDS and LLDAS-5 that is sustained for all subsequent visits up to and including Week 52, 4. Proportion of participants who achieve DORIS, LLDS and LLDAS-5 that is sustained for three or more consecutive visits, 5. Time to first DORIS, LLDS and LLDAS-5 that is sustained through to Week 52

Source: https://euclinicaltrials.eu/ctis-public/view/2025-523670-17-00